EU clinical trial 2024-515860-29-00: Randomized controlled trial evaluating the impact of mineralocorticoid receptor blockade by eplerenone on echocardiographic abnormalities among kidney graft recipient under calcineurin inhibitors. KT-CANOPY: Cardiac improvement by eplerenone among patients under cyclosporine or tacrolimus for kidney transplantation.
Protocol code: 2019PI092
Sponsor: CHRU De Nancy (Hospital/Clinic/Other health care facility). Phase: Therapeutic confirmatory (Phase III). Countries: France (authorised, recruitment pending).
Therapeutic area(s): Diseases [C] - Cardiovascular Diseases [C14]
Gender: Female, Male. Age: 18-64 years, 65+ years. Enrolment: 132.
Status: Authorised, recruitment pending. Decision date: 2025-03-07. Results received: No. Last updated: 2026-05-28.

Condition(s): kidney transplantation
Product: EPLERENONE

Primary endpoint: Hierarchized composite criterion evaluated at 36 weeks (win ratio method), including in order of priority: 1/ Death or hospitalization for heart failure or acute coronary syndrome, 2/ Variation in indexed left ventricular mass (LVMi) (with a precision of 5 g/m² allowing patients with a difference in variation LVMi between randomization and 36 weeks of less than 5 g/m² to be considered as tied), 3/Variation in indexed left atrial volume.
Endpoint(s): Evolution o f parameters of systolic function (LVEF, strain), remodeling (left ventricular and atrial volumes) and filling pressures (E/e', deceleration time, PAPs) at 36 weeks, Evolution of peripheral systolic blood pressure (pSBP in mmHg), peripheral diastolic blood pressure (pDBP in mmHg), peripheral pulse pressure (pPP in mmHg) at 36 weeks, Evolution of Nt-ProBNP concentration at randomisation, 12 and 36 weeks., Evolution of collagen biomarkers (PICP and PIIINP) performed at randomisation, at 12 weeks and at 36 weeks, Evolution of Biological markers of endothelial dysfunction (endothelin, soluble endothelium selectin (sE-selectin), von Willebrand factor) performed at randomization, at 12 weeks, at 36 weeks, Graft function assessed with serum creatinine (micromol/L) with estimation of glomerular filtration rate (eGFR in mL/min/1.73m2) according to the CKD-EPI formula, as well as proteinuria measured by the proteinuria/creatininuria ratio (mg/g). The percentage of patients with GFR ≥ 90, 60-89, 45-59, 30-44, 15-29, <15ml/min/1.73m2 will also be assessed, as well as the percentage of patients with proteinuria/creatininuria ratio <500; 500-1000, 1000-2000, 2000-3000, >3000mg/g at 36Weeks, The occurrence of hyperkalaemia between 5 - 5.49; 5.5 - 6; >6mmol/L during 36 weeks follow-up, The risk of acute renal failure defined by an increase in creatinine > 50% during follow-up for 36 weeks, The echocardiographic characteristics: parameters of systolic function (LVEF, strain), remodeling (ventricular and left atrial volumes), and filling pressures (E/e', deceleration time, PAPs).

Source: https://euclinicaltrials.eu/ctis-public/view/2024-515860-29-00